EU clinical trial 2024-517484-23-00: A multicenter, randomized, double-blind, placebo-controlled study to evaluate the efficacy of immunosuppression in biopsy-proven virus-negative myocarditis or inflammatory cardiomyopathy (IMPROVE-MC).
Protocol code: IMPROVE-MC
Sponsor: Medical University Of Warsaw (Educational Institution). Phase: Therapeutic use (Phase IV). Countries: Poland (ongoing, recruiting).
Therapeutic area(s): Diseases [C] - Cardiovascular Diseases [C14]
Gender: Female, Male. Age: 18-64 years, 65+ years. Enrolment: 100.
Status: Ongoing, recruiting. Start date (EU): 2022-07-26. Decision date: 2024-11-05. Results received: No. Last updated: 2026-08-04.

Condition(s): Myocarditis, inflammatory cardiomyopathy
Product: Placebo Azathioprine, Encorton, 10 mg, tabletki, Placebo Encorton 10 mg, Encorton, 5 mg, tabletki, AZATHIOPRINE VIS, 50 mg, tabletki, Placebo Encorton 5 mg

Primary endpoint: LVEF at 12 – months.
Endpoint(s): Proportion of patients who responded to immunosuppressive therapy as defined by an LVEF increase of ≥ 10% over time., LVEF at 12 months in subgroups of patients with baseline LVEF ≤ 30% and > 30%, Change in the LV end-systolic and end-diastolic dimensions as well as the LV end-systolic and end-diastolic volumes over time., Change from baseline in NYHA class over time., Occurrence of adjudicated heart failure decompensation (hospitalization or ambulatory visit)., LVEF at 24 months (maintenance or further improvement)., LVEF at 24 months (maintenance or further improvement) in subgroups of patients with baseline LVEF ≤30% and >30%, Change in the LV end-systolic and end-diastolic dimensions as well as the LV end-systolic and end-diastolic volumes over time. (13-24 months), Change in NYHA class over time. (13-24 months), Occurrence of adjudicated heart failure decompensation (hospitalization or ambulatory visit). (13-24 months)

Source: https://euclinicaltrials.eu/ctis-public/view/2024-517484-23-00